EU clinical trial 2024-519622-20-00: A Study to assess the Safety, Tolerability and effect of RO7673396 when used alone as well as with other cancer medications in participants with Advanced Solid Tumors
Protocol code: YO45758
Sponsor: F. Hoffmann-La Roche AG (Pharmaceutical company). Phase: Human Pharmacology (Phase I)- First administration to humans. Countries: Germany (authorised, recruitment pending), Netherlands (authorised, recruitment pending), Spain (ongoing, recruiting), Denmark (ongoing, recruiting), France (authorised, recruitment pending), Belgium (authorised, recruitment pending).
Therapeutic area(s): Diseases [C] - Neoplasms [C04]
Gender: Female, Male. Age: 18-64 years, 65+ years. Enrolment: 70.
Start date (EU): 2026-02-27. Decision date: 2025-09-22. Results received: No. Last updated: 2026-07-16.
Decision dates by country: FR: 2025-09-29, DK: 2025-09-22, DE: 2025-09-23, ES: 2025-09-25, NL: 2025-09-26, BE: 2025-09-23

Condition(s): Advanced Solid Tumors Harboring RAS Mutation(S)

Source: https://euclinicaltrials.eu/ctis-public/view/2024-519622-20-00